EU clinical trial 2024-518785-28-00: A low-intervention prospective-retrospective study to evaluate the pharmacokinetics of elexacaftor/tezacaftor/ivacaftor combination in a Cystic Fibrosis population
Protocol code: PKCAFTORs
Sponsor: IRCCS Istituto Giannina Gaslini (Hospital/Clinic/Other health care facility). Phase: Therapeutic use (Phase IV). Countries: Italy (authorised, recruitment pending).
Therapeutic area(s): Diseases [C] - Congenital, Hereditary, and Neonatal Diseases and Abnormalities [C16]; Diseases [C] - Respiratory Tract Diseases [C08]
Gender: Female, Male. Age: 0-17 years, 18-64 years, 65+ years. Enrolment: 50.
Status: Authorised, recruitment pending. Decision date: 2025-09-24. Results received: No. Last updated: 2025-09-24.

Condition(s): Cystic Fibrosis
Product: Kaftrio 37.5 mg/25 mg/50 mg film-coated tablets, Kalydeco 75 mg film-coated tablets, Kalydeco 150 mg film-coated tablets, Kaftrio 75 mg/50 mg/100 mg film-coated tablets

Primary endpoint: Plasma concentrations of ELX, TEZ and IVA at steady-state (Css).
Endpoint(s): Population pharmacokinetics (popPK) analysis of ELX, TEZ and IVA at steady state., Harvest of every AE/Adverse Drug Reaction (ADR)., Correlation between PK of ELX, TEZ and IVA and number of AEs, Correlation between PK and ETI efficacy (ppFEV1 and Cl- values at T0) in the 3 groups classifications (responders, non responders and unresolved responders) of ETI

Source: https://euclinicaltrials.eu/ctis-public/view/2024-518785-28-00